EU clinical trial 2026-526434-21-00: Systemic Bioavailability and Bioequivalence of Topical Diclofenac Fysioline 23.2 mg/g gel compared with Diclofenac Diethylamine - Voltaren Forte 2.32% gel
Sponsor: Fysioline Oy (Pharmaceutical company). Phase: Human Pharmacology (Phase I)- Bioequivalence Study. Countries: Finland (ongoing, recruiting).
Therapeutic area(s): Analytical, Diagnostic and Therapeutic Techniques and Equipment [E] - Anesthesia and Analgesia [E03]
Gender: Female, Male. Age: 18-64 years. Enrolment: 34.
Status: Ongoing, recruiting. Start date (EU): 2026-07-01. Decision date: 2026-06-24. Results received: No. Last updated: 2026-06-30.
Decision dates by country: FI: 2026-06-30

Condition(s): Bioequivalence, musculoskeletal pain pain

Source: https://euclinicaltrials.eu/ctis-public/view/2026-526434-21-00